EU clinical trial 2025-523802-34-00: An Adaptive Dose Escalation and Expansion Basket Trial to Explore the Safety, Pharmacology, and Clinical Activity of TGD001 in Immune-Mediated Thrombotic Thrombocytopenic Purpura (iTTP) and Other Thrombotic Microangiopathies
Protocol code: TG1-CL-301
Sponsor: TargED Biopharmaceuticals B.V. (Pharmaceutical company). Phase: Phase I and Phase II (Integrated)- Other. Countries: Germany (authorised, recruitment pending), France (authorised, recruitment pending), Italy (authorised, recruitment pending), Spain (authorised, recruitment pending).
Therapeutic area(s): Diseases [C] - Hemic and Lymphatic Diseases [C15]
Gender: Female, Male. Age: 18-64 years, 65+ years. Enrolment: 40.
Status: Authorised, recruitment pending. Decision date: 2026-03-06. Results received: No. Last updated: 2026-06-24.
Decision dates by country: FR: 2026-03-11, DE: 2026-03-06, ES: 2026-03-09, IT: 2026-03-10

Condition(s): Immune-Mediated Thrombotic Thrombocytopenic Purpura, Thrombotic microangiopathy

Primary endpoint: Treatment emergent adverse events
Endpoint(s): Time to clinical response, Change in platelet count from baseline, Time to recovery of platelets to ≥150×10E9/L, Change of organ damage markers from baseline, Time to recovery of LDH to ≤2 × ULN, Assessment or improvement (improvement of ≥1 grade in CTCAE v5.0 scale) of disease-related signs and symptoms within 90 days post intervention (by number of unique participants and by total number of AEs), Number of days in the intensive care unit and the number of days hospitalized, All-cause and disease-specific mortality within 90 days post-intervention, Plasma concentrations of TGD001, PK parameters such as Cmax, Tmax, AUC, t1/2, Development of ADA

Source: https://euclinicaltrials.eu/ctis-public/view/2025-523802-34-00